EU clinical trial 2024-512299-37-00: A Phase 1 Study for ZW191 in Participants with Solid Tumors
Protocol code: ZWI-ZW191-101
Sponsor: Zymeworks Inc. (Pharmaceutical company). Phase: Human Pharmacology (Phase I)- First administration to humans. Countries: Spain (ongoing, recruiting).
Therapeutic area(s): Diseases [C] - Respiratory Tract Diseases [C08]; Diseases [C] - Neoplasms [C04]; Diseases [C] - Female Urogenital Diseases and Pregnancy Complications [C13]
Gender: Female, Male. Age: 18-64 years, 65+ years. Enrolment: 18.
Status: Ongoing, recruiting. Start date (EU): 2026-02-18. Decision date: 2025-03-21. Results received: No. Last updated: 2026-02-17.

Condition(s): Advanced solid tumors

Source: https://euclinicaltrials.eu/ctis-public/view/2024-512299-37-00